EU clinical trial 2023-503488-40-00: A 12-Week, Phase 2 Open-Label, Sequential Dose Cohort Study to Evaluate the Safety, Efficacy, and Pharmacokinetics of CRN04894 Treatment in Participants with Congenital Adrenal Hyperplasia
Protocol code: CRN04894-03
Sponsor: Crinetics Pharmaceuticals Inc. (Pharmaceutical company). Phase: Therapeutic exploratory (Phase II). Countries: Germany (ended), Italy (ended).
Therapeutic area(s): Diseases [C] - Hormonal diseases [C19]; Diseases [C] - Congenital, Hereditary, and Neonatal Diseases and Abnormalities [C16]
Gender: Female, Male. Age: 18-64 years, 65+ years. Enrolment: 12.
Status: Ended. Start date (EU): 2023-11-27. End date (EU): 2024-11-07. End date: 2025-08-22. Decision date: 2023-09-26. Results received: No. Last updated: 2024-10-24.
Decision dates by country: DE: 2023-09-26, IT: 2023-09-26

Condition(s): CONGENITAL ADRENAL HYPERPLASIA
Product: METHYLPREDNISOLONE, PREDNISOLONE, FLUDROCORTISONE, HYDROCORTISONE

Primary endpoint: Primary Safety Endpoints: Incidence of treatment-emergent adverse events (TEAEs), including treatment-emergent serious adverse events (SAEs) and any adverse events (AEs) leading to discontinuation, Primary Efficacy Endpoint: Change from Baseline in morning (before 11:00) serum A4 at Week 12
Endpoint(s): Secondary Efficacy Endpoint: Change from Baseline in morning (before 11:00) serum 17-OHP at Week 12

Source: https://euclinicaltrials.eu/ctis-public/view/2023-503488-40-00